EU clinical trial 2025-521462-96-00: A Phase 1b, Open-Label Study of CLN-978 for the Treatment of Active, Moderate to Severe Sjogren’s Disease
Protocol code: CLN-978-SJ-101
Sponsor: Cullinan Therapeutics Inc. (Pharmaceutical company). Phase: Human Pharmacology (Phase I)- Other. Countries: Germany (ongoing, recruiting), France (ongoing, recruiting), Italy (authorised, recruiting), Poland (authorised, recruitment pending).
Therapeutic area(s): Diseases [C] - Immune System Diseases [C20]
Gender: Female, Male. Age: 18-64 years, 65+ years. Enrolment: 40.
Start date (EU): 2025-08-05. Decision date: 2025-07-04. Results received: No. Last updated: 2026-05-06.
Decision dates by country: IT: 2025-11-14, FR: 2025-11-10, DE: 2025-07-04, PL: 2026-05-06

Condition(s): Sjogren's Disease

Source: https://euclinicaltrials.eu/ctis-public/view/2025-521462-96-00